EU clinical trial 2023-508520-36-00: A long-term, double-blind, randomised, placebo-controlled clinical trial to investigate the efficacy and safety of PQ Grass 27600 SU in children and adolescents with seasonal allergic rhinitis/rhinoconjunctivitis induced by grass pollen exposure
Protocol code: PQGrass308
Sponsor: Allergy Therapeutics (UK) Limited (Pharmaceutical company). Phase: Therapeutic confirmatory (Phase III). Countries: Slovakia (ongoing, recruiting), Czechia (ongoing, recruiting), Bulgaria (ongoing, recruiting), Romania (ongoing, recruiting), Poland (ongoing, recruiting), Germany (ongoing, recruiting), Lithuania (ongoing, recruiting).
Therapeutic area(s): Diseases [C] - Immune System Diseases [C20]
Gender: Female, Male. Age: 0-17 years. Enrolment: 358.
Status: Ongoing, recruiting. Start date (EU): 2024-09-06. Decision date: 2024-06-12. Results received: No. Last updated: 2026-05-25.
Decision dates by country: SK: 2024-06-12, PL: 2024-06-14, RO: 2024-06-17, LT: 2024-06-17, DE: 2024-06-17, CZ: 2024-06-14, BG: 2024-06-17

Condition(s): Seasonal allergic rhinitis/rhinoconjunctivitis induced by grass pollen exposure
Product: DESLORATADINE, Pollinex Quattro Grass 1.0 ml, Prick-Testlösung B2 Gräserpollen 10.000 DU/ml ODC, LORATADINE, Placebo with MCT, suspension for injection, subcutaneous use, PREDNISOLONE, DESLORATADINE, PREDNISONE, Bencard Prick-Testlösung Negativ-Kontrolle, Histamin-Kontrollösung 1% Pricktestlösung Wirkstoff: Histamindihydrochlorid, MOMETASONE FUROATE MONOHYDRATE, OLOPATADINE HYDROCHLORIDE, LORATADINE, PREDNISOLONE

Primary endpoint: -Part A: The CSMS averaged over the peak GPS during Year 1., -Part B: The CSMS averaged over the peak GPS after 2 years of treatment-free follow-up.
Endpoint(s): Part A Efficacy: - The CSMS averaged over the entire (or truncated) GPS. - The dSS component of the CSMS averaged over the peak GPS. - The dMS component of the CSMS averaged over the peak GPS., - The TCS averaged over the peak GPS. - The probability of well days and severe days during the peak GPS. - Serum grass specific IgG4 at Visit 11 compared to Part A Visit 1 (baseline). - Change from Part A Visit 2 (baseline) to Visit 11 in PRQLQ, AdolRQLQ and RQLQ(S) measured in selected countries., Part A Safety: - Frequency, severity and relationship of AEs to treatment. - Frequency of AEs leading to premature discontinuation from treatment or trial. - Frequency of AESI., - Changes in clinical laboratory values (serum chemistry, haematology, urinalysis) between screening and Visit 11. - Changes in vital signs (all subjects) and spirometry/PEFR (only in subjects with past or current asthma) at all treatment visits., Part B Efficacy: Key secondary endpoints: - The CSMS averaged over the peak GPS after 3 years of treatment. - The TCS averaged over the peak GPS after 3 years of treatment. - The TCS averaged over the peak GPS after 2 years of treatment-free follow-up., - The CSMS averaged over the entire (or truncated) GPS after 3 years of treatment. - The dSS component of the CSMS averaged over the peak GPS after 2 years of treatment-free follow-up. - The dMS component of the CSMS averaged over the peak GPS after 2 years of treatment-free follow-up. - Serum grass specific IgG4 after 3 years of treatment compared to Part B Visit 1 (baseline)., Part B Efficacy: Other secondary endpoints: - The CSMS averaged over the peak GPS after 1 and 2 years of treatment and 1 year of treatment-free follow-up. - The CSMS averaged over the entire (or truncated) GPS after 1 and 2 years of treatment and 1 and 2 years of treatment-free follow-up. - The TCS averaged over the peak GPS after 1 and 2 years of treatment and 1 year of treatment-free follow-up., - The dSS component of the CSMS averaged over the peak GPS after 1, 2 and 3 years of treatment and 1 and 2 years of treatment-free follow-up. - The dMS component of the CSMS averaged over the peak GPS after 1, 2 and 3 years of treatment and 1 and 2 years of treatment-free follow-up. - The probability of well days and severe days during the peak GPS after 1, 2 and 3 years of treatment and 1 and 2 years of treatment-free follow-up., - Serum grass specific IgG4 after 1 and 2 years of treatment compared to Part B Visit 1 (baseline). - Changes from Part B Visit 2 (baseline) in RQLQ(S), PRQLQ and AdolRQLQ measured in selected countries, after 1, 2 and 3 years of treatment and 1 and 2 years of treatment-free follow-up., Part B Safety: - Frequency, severity and relationship of AEs to treatment. - Frequency of AEs leading to premature discontinuation from treatment or trial. - Frequency of AESI., - Changes in clinical laboratory values (serum chemistry, haematology, urinalysis). - Changes in vital signs (all subjects) and spirometry/PEFR (only in subjects with past or current asthma) at all treatment visits.

Source: https://euclinicaltrials.eu/ctis-public/view/2023-508520-36-00